EU clinical trial 2024-520238-31-01: A Phase Ib/II, multi-site, open-label, two-part trial to evaluate the efficacy, safety, pharmacokinetics, and recommended combination dose of BNT324 with BNT327 in participants with advanced lung cancer
Protocol code: BNT324-01
Sponsor: BioNTech SE (Pharmaceutical company). Phase: Phase I and Phase II (Integrated)- Other. Countries: Spain (ongoing, recruiting), France (ongoing, recruiting), Italy (ongoing, recruiting), Poland (ongoing, recruiting).
Therapeutic area(s): Diseases [C] - Neoplasms [C04]
Gender: Female, Male. Age: 18-64 years, 65+ years. Enrolment: 112.
Status: Ongoing, recruiting. Start date (EU): 2026-04-20. Decision date: 2026-02-24. Results received: No. Last updated: 2026-06-01.
Decision dates by country: IT: 2026-03-10, PL: 2026-03-13, ES: 2026-03-02, FR: 2026-02-24

Condition(s): Advanced Lung Cancer
Product: BNT327, BNT324

Primary endpoint: Part 1 - Occurrence of dose limiting toxicities (DLTs) during the DLT evaluation period, Part 1 - Occurrence of Treatment-emergent adverse events (TEAEs), serious TEAEs, treatment-related TEAEs, and treatment-related serious TEAEs from the time of the first dose of IMP to 90 days after the last IMP dose or until new anticancer therapy is started, whichever occurs first, Part 1 - Occurrence of dose interruption, reduction, and treatment discontinuations due to TEAEs by dose level from the time of the first dose of IMP to 90 days after the last dose of IMP or until new anticancer therapy is started, whichever occurs first, Part 2 cohorts 1 and 2 - Occurrence of TEAEs, serious TEAEs, treatment-related TEAEs, and treatment-related serious TEAEs from the time of the first dose of IMP to 90 days after the last IMP dose or until new anticancer therapy is started, whichever occurs first, Part 2 cohorts 1 and 2 - Occurrence of dose interruption, reduction, and treatment discontinuation due to TEAEs from the time of the first dose of IMP to 90 days after the last IMP dose or until new anticancer therapy is started, whichever occurs first, Part 2 cohorts 1 and 2 - Objective response rate (ORR) defined as the proportion of participants in whom a confirmed complete response (CR) or partial response (PR) is observed as best overall response (per response evaluation criteria in solid tumors [RECIST] version v1.1 based on the investigator’s assessment)., Part 2 cohorts 3-7 - ORR defined as the proportion of participants in whom a confirmed CR or PR is observed as best overall response (per RECIST version v1.1 based on the investigator’s assessment).
Endpoint(s): Part 1 - ORR defined as the proportion of participants in whom a confirmed CR or PR is observed as best overall response (per RECIST version v1.1 based on the investigator’s assessment)., Part 1 - Disease control rate (DCR), defined as the proportion of participants with confirmed CR, PR, or stable disease (SD) as best overall response (per RECIST version v1.1 based on the investigator’s assessment)., Part 2 all cohorts - PFS defined as the time from first dose of IMP to the first objective tumor progression (PD) or death from any cause, whichever occurs first, per RECIST v1.1 based on the investigator’s assessment., Part 2 all cohorts - Duration of response (DOR), defined as the time from first objective response (CR or PR) to first occurrence of objective tumor progression (PD) or death from any cause, whichever occurs first (per RECIST v1.1 based on the investigator’s assessment)., Part 2 all cohorts - Overall survival (OS), defined as the time from first dose of IMP to death from any cause., Part 2 all cohorts - DCR, defined as the proportion of participants with confirmed CR, PR, or SD as best overall response (per RECIST v1.1 based on the investigator’s assessment)., Part 2 all cohorts - Time to response (TTR), defined as the time from first dose of IMP to first objective response (CR or PR per RECIST v1.1 based on the investigator’s assessment), Part 2 cohorts 3-7 - Occurrence of TEAEs, serious TEAEs, treatment-related TEAEs, and treatment-related serious TEAEs from the time of the first dose of IMPs to 90 days after the last IMP dose or until new anticancer therapy is started, whichever occurs first., Part 2 cohorts 3-7 - Occurrence of dose interruption, reduction, and treatment discontinuation due to TEAEs from the time of the first dose of IMP to 90 days after the last IMP dose or until new anticancer therapy is started, whichever occurs first

Source: https://euclinicaltrials.eu/ctis-public/view/2024-520238-31-01